EU clinical trial 2023-508302-24-00: A Phase II Open-Label Study of Sacituzumab Govitecan in Unresectable Locally Advanced/Metastatic Urothelial Cancer
Protocol code: IMMU-132-06
Sponsor: Gilead Sciences Inc. (Pharmaceutical company). Phase: Therapeutic exploratory (Phase II). Countries: Spain (ongoing, recruiting), Italy (ongoing, recruiting), France (ongoing, recruiting), Germany (ongoing, recruiting), Greece (ongoing, recruiting).
Therapeutic area(s): Diseases [C] - Neoplasms [C04]
Gender: Female, Male. Age: 18-64 years, 65+ years. Enrolment: 116.
Status: Ongoing, recruiting. Start date (EU): 2019-05-07. Decision date: 2024-01-08. Results received: No. Last updated: 2026-04-13.
Decision dates by country: GR: 2024-02-23, ES: 2024-01-08, DE: 2024-01-12, IT: 2024-01-11, FR: 2024-01-08

Condition(s): Locally Advanced/Metastatic Urothelial Cancer
Product: Gemcitabine Accord 100 mg/ml koncentratas infuziniam tirpalui, Cisplatin 1 mg/ml Concentrate for Solution for Infusion, Padcev 30 mg powder for concentrate for solution for infusion, Zimberelimab, CARBOPLATINE MEDAC 10 mg/mL, solution à diluer pour perfusion, DOMVANALIMAB, KEYTRUDA 25 mg/mL concentrate for solution for infusion, Bavencio 20 mg/mL concentrate for solution for infusion, Trodelvy 200 mg powder for concentrate for solution for infusion

Primary endpoint: The primary endpoint in Cohorts 1 to 4 is ORR based on central review (Cohorts 1 and 2) or BICR (Cohorts 3 and 4) as assessed by RECIST 1.1 criteria. In Cohort 5, the primary endpoint is PFS based on BICR as assessed by RECIST 1.1 criteria., In Cohort 6, the primary endpoint is ORR based on BICR as assessed by RECIST 1.1 criteria., In Cohort 7, the primary efficacy endpoint is confirmed ORR based on investigator review as assessed by RECIST 1.1 criteria.
Endpoint(s): Secondary efficacy endpoints for Cohorts 1 and 2 are DOR and PFS based on central review as assessed by RECIST 1.1 criteria and OS. Secondary efficacy endpoints for Cohorts 3 and 4 are DOR, CBR, and PFS based on BICR as assessed by RECIST 1.1 criteria; ORR, DOR, CBR, and PFS based on investigator assessment by RECIST 1.1 criteria; and OS. In Cohorts 3 and 4, ORR, DOR, CBR, and PFS will also be evaluated by the investigator according to iRECIST criteria., In Cohort 5, the secondary efficacy endpoint is OS. In Cohort 6, secondary efficacy endpoints are DOR, CBR, and PFS based on BICR as assessed by RECIST 1.1 criteria; ORR, DOR, CBR, and PFS based on investigator assessment by RECIST 1.1 criteria; and OS. In Cohort 6, ORR, DOR, CBR, and PFS will also be evaluated by the investigator according to iRECIST criteria., In Cohort 7, secondary efficacy endpoints are ORR based on BICR by RECIST 1.1 criteria; DOR, CBR, and PFS based on investigator review and BICR by RECIST 1.1 criteria; and OS. Additionally, ORR, DOR, CBR, and PFS will be evaluated by the investigator according to iRECIST criteria.

Source: https://euclinicaltrials.eu/ctis-public/view/2023-508302-24-00